EU clinical trial 2024-514595-41-00: Two part (double-blind inclisiran versus placebo [Year 1] followed by open-label inclisiran [Year 2]) randomized multicenter study to evaluate safety, tolerability and efficacy of inclisiran in children (2 to less than 12 years) with homozygous familial hypercholesterolemia and elevated LDL-cholesterol (ORION-19)
Protocol code: CKJX839C12304
Sponsor: Novartis Pharma AG (Pharmaceutical company). Phase: Therapeutic confirmatory (Phase III). Countries: Spain (authorised, recruitment pending), Greece (ongoing, recruiting), Germany (ongoing, recruiting), Netherlands (authorised, recruitment pending), France (authorised, recruitment pending), Austria (authorised, recruitment pending).
Therapeutic area(s): Diseases [C] - Cardiovascular Diseases [C14]
Gender: Female, Male. Age: 0-17 years. Enrolment: 8.
Start date (EU): 2025-08-05. Decision date: 2025-01-21. Results received: No. Last updated: 2026-05-08.
Decision dates by country: NL: 2025-01-21, FR: 2025-01-21, DE: 2025-01-23, ES: 2025-01-21, AT: 2025-01-27, GR: 2025-01-22

Condition(s): homozygous familial hypercholesterolemia
Product: INCLISIRAN, KJX839, Placebo to KJX839 (Inclisiran) 0 mg/1.5 mL Solution for injection in vial

Primary endpoint: Percentage change in LDL-C from baseline to Day 330 (Year 1)
Endpoint(s): Time-adjusted percent change in LDL-C from baseline after Day 90 and up to Day 330 (Year 1), Percent change and absolute change in LDL-C, PCSK9, total cholesterol, Apo B, non-HDL-C, Lp(a), triglycerides, HDL-C, VLDL-C and Apo A1 from baseline to each assessment time up to Day 720 (Year 2), Incidence, severity and relationship to study drug of treatment-emergent AEs and SAEs; vital signs; laboratory parameters; ADA measurement; growth (height, weight, BMI); pubertal development (sexual hormones and Tanner staging)

Source: https://euclinicaltrials.eu/ctis-public/view/2024-514595-41-00